EU clinical trial 2022-501038-48-00: HOVON 152 DLBCL. A phase II study evaluating the effect of DA-EPOCH-R induction followed by nivolumab consolidation in patients with newly diagnosed high grade B cell lymphoma (HGBL) with MYC and BCL2 and/or BCL6 rearrangements
Protocol code: HO152
Sponsor: Stichting Hemato-Oncologie voor Volwassenen Nederland (Hovon) (Hospital/Clinic/Other health care facility). Phase: Therapeutic exploratory (Phase II). Countries: Netherlands (ongoing, recruitment ended), Belgium (ongoing, recruitment ended).
Therapeutic area(s): Diseases [C] - Neoplasms [C04]
Gender: Female, Male. Age: 18-64 years, 65+ years. Enrolment: 97.
Status: Ongoing, recruitment ended. Start date (EU): 2018-07-26. Decision date: 2023-04-26. Results received: No. Last updated: 2024-06-14.
Decision dates by country: BE: 2023-06-01, NL: 2023-04-26

Condition(s): Diffuse Large B-Cell Lymphoma
Product: RITUXIMAB, DOXORUBICIN HYDROCHLORIDE, PREDNISOLONE, VINCRISTINE SULFATE, OPDIVO 10 mg/mL concentrate for solution for infusion., ETOPOSIDE, CYCLOPHOSPHAMIDE

Primary endpoint: 12 months DFS (defined as time from registration for consolidation to disease relapse or death, whichever comes first) of patients in CMR as assessed by end of DA-EPOCH-R treatment 18F-FDG PET-CT.
Endpoint(s): CMR rate on 18F-FDG PET-CT after DA-EPOCH-R, 18 months PFS (defined as time from registration to disease progression, relapse or death, whichever comes first), 18 months OS (defined as time from registration until death from any cause; patients still alive or lost to follow up are censored at the date they were last known to be alive) of all patients, 12 months overall survival under consolidation (OSc), defined as time from registration for consolidation until death from any cause. Patients still alive or lost to follow up are censored at the date they were last known to be alive, Rate of CTCAE grade >=2 toxicities, Rate of conversion to MRD negativity during consolidation, Assessment of the predictive value of mid-treatment 18F-FDG PET-CT with respect to CMR at the end of DA-EPOCH-R therapy, Association of PD1/PDL1 expression in relation NGS, GEP and to outcome, Association of MRD measurements by circulating tumor DNA and microRNA, Association of T cell subsets and clonality during nivolumab treatment and to MRD

Source: https://euclinicaltrials.eu/ctis-public/view/2022-501038-48-00